EU clinical trial 2025-523880-39-02: A novel fibroblast imaging biomarker and ultrahigh resolution PET to improve the diagnosis and follow-up of giant cell arteritis
Sponsor: UZ Leuven (Hospital/Clinic/Other health care facility). Phase: Phase II and Phase III (Integrated). Countries: Belgium (ongoing, recruiting).
Therapeutic area(s): Diseases [C] - Cardiovascular Diseases [C14]; Diseases [C] - Immune System Diseases [C20]
Gender: Female, Male. Age: 18-64 years, 65+ years. Enrolment: 60.
Status: Ongoing, recruiting. Start date (EU): 2026-05-04. Decision date: 2026-02-09. Results received: No. Last updated: 2026-02-09.

Condition(s): Giant Cell Arteritis

Primary endpoint: Ability to visualize activate arteritis of the ophthalmic artery. Diagnostic accuracy (AUC – combined sensitivity and specifity) of FDG and FAPI PET for diagnosing GCA. Ability to visualize to identify chronic pathological fibroblast activation on FAPI PET. Demontsrate a correlation between FAP+ fibroblast cell state and FAPI PET parameters at clinical diagnosis and remission. Additional primary endpoints related to the clinical investigational NeuroEXPLORER device : See Master Protocol
Endpoint(s): To distinguish GCA from non-GCA causes in patients presenting with vision loss. . To evaluate the evolution of FAPI and FDG uptake from active disease to remission. To identify other import cell types in the pathogenesis of GCA using single nuclei RNA sequencing. Additional secondary endpoints related to the clinical investigational NeuroEXPLORER device: See Master Protocol EUDAMED_ CIV-25-06-053398.

Source: https://euclinicaltrials.eu/ctis-public/view/2025-523880-39-02